EU clinical trial 2024-515357-16-00: NK4AML: Infusion of ex vivo-generated allogeneic natural killer cells in combination with subcutaneous IL-2 in patients with acute myeloid leukemia: a phase I/IIa study
Protocol code: HEMAML42-NK4AML
Sponsor: Stichting Radboud universitair medisch centrum (Hospital/Clinic/Other health care facility). Phase: Therapeutic exploratory (Phase II). Countries: Netherlands (ongoing, recruitment ended).
Therapeutic area(s): Diseases [C] - Neoplasms [C04]
Gender: Female, Male. Age: 18-64 years, 65+ years. Enrolment: 16.
Status: Ongoing, recruitment ended. Start date (EU): 2025-01-20. Decision date: 2025-01-20. Results received: No. Last updated: 2025-01-20.

Condition(s): MDS with excess blasts, MDS/AML or AML patients
Product: Proleukin 18 x 106 IE Poeder voor oplossing voor injectie of infusie

Primary endpoint: During the phase I safety study, patients will be evaluated intensively for toxicity caused by the RNK001 NK cell infusions, whether or not followed by SC IL-2, using the CTCAE toxicity criteria and graft versus host disease (GvHD) classification criteria, defining dose limiting toxicities (DLTs). For phase IIa of the study, clinical response to therapy is the main study parameter and will be defined according to European Leukemia Network (ELN) response criteria by day +28 post NK cell adminis.

Source: https://euclinicaltrials.eu/ctis-public/view/2024-515357-16-00